EU clinical trial 2024-519832-17-00: Perineural incobotulinumtoxin-A for Complex Regional Pain Syndrome - An open-label feasibility study (PINCom)
Sponsor: Rigshospitalet (Hospital/Clinic/Other health care facility). Phase: Therapeutic exploratory (Phase II). Countries: Denmark (ended).
Therapeutic area(s): Diseases [C] - Nervous System Diseases [C10]
Gender: Female, Male. Age: 18-64 years, 65+ years. Enrolment: 25.
Status: Ended. Start date (EU): 2026-01-07. End date (EU): 2026-04-15. Decision date: 2025-10-13. Results received: Yes. Last updated: 2026-02-25.

Condition(s): Complex Regional Pain Syndrome
Product: XEOMIN 200 units powder for solution for injection

Primary endpoint: Overall feasibility analysis of a full scale trial, based on patient and investigator feedback, recruitment-, inclusion- and, completion- percentages and rates
Endpoint(s): Documentation of flare-up symptoms post-injection, Qualiative analysis of patient interviews on treatment, effects, and participation burden., Estimates of effect size on pain reduction for use in future power calculations.

Source: https://euclinicaltrials.eu/ctis-public/view/2024-519832-17-00